EU clinical trial 2024-518792-54-00: Phase II study on Venetoclax (VEN) plus Decitabine (DEC) (VEN-DEC) for elderly (≥60 <75years) patients with newly diagnosed Acute Myeloid Leukemia (AML) elegible for allogeneic Stem Cell Transplantation (allo-SCT)
Protocol code: VEN-DEC GITMO
Sponsor: Gruppo Italiano Per Il Trapianto Di Midollo Osseo Cellule Staminali Emopoietiche E Terapia Cellulare (Patient organisation/association). Phase: Therapeutic exploratory (Phase II). Countries: Italy (ended).
Therapeutic area(s): Diseases [C] - Hemic and Lymphatic Diseases [C15]
Gender: Female, Male. Age: 18-64 years, 65+ years. Enrolment: 100.
Status: Ended. Start date (EU): 2021-05-13. End date (EU): 2026-01-31. Decision date: 2024-12-16. Results received: Yes. Last updated: 2025-11-25.

Condition(s): Acute Myeloid Leukemia (AML)
Product: Dacogen 50 mg powder for concentrate for solution for infusion., Venclyxto 100 mg film-coated tablets

Primary endpoint: Proportion of elderly (≥60 - <75 years) patients with newly diagnosed AML eligible for allo-SCT treated with the “chemo-free” combination Venetoclax plus Decitabine (VEN-DEC) who get allo-SCT in CR/CRi/MLFS.
Endpoint(s): - Efficacy of VEN-DEC combination - Cumulative incidence of graft failure at +30 days, +100 days from transplant - Outcome of allo-SCT in term of NRM at day +100, 1 year and 2 years from allo-SCT - Cumulative incidence and severity of acute GvHD at 100 days after transplant - Cumulative incidence and severity of chronic GvHD at 1 and 2 years post transplant - RI at 1 and 2 year after transplantation from days of transplant. - OS at 1 and 2 years post transplant - DFS at 1 and 2 years post

Source: https://euclinicaltrials.eu/ctis-public/view/2024-518792-54-00